EU clinical trial 2023-508737-13-00: A Phase 2, Randomized, Double-Blind, Placebo-Controlled Clinical Study to Assess the Safety and Effectiveness of Tovinontrine in Patients With Chronic Heart Failure With Preserved Ejection Fraction
Protocol code: CRD-750-202
Sponsor: Cardurion Pharmaceuticals Inc. (Pharmaceutical company). Phase: Therapeutic exploratory (Phase II). Countries: Czechia (ended), Bulgaria (ended), Netherlands (ended), Spain (ended), Poland (ended), Germany (ended), Italy (ended), Hungary (ended), Belgium (ended).
Therapeutic area(s): Diseases [C] - Cardiovascular Diseases [C14]
Gender: Female, Male. Age: 18-64 years, 65+ years. Enrolment: 128.
Status: Ended. Start date (EU): 2024-08-08. End date (EU): 2025-08-29. End date: 2025-09-03. Decision date: 2024-05-29. Results received: No. Last updated: 2025-06-12.
Decision dates by country: CZ: 2024-05-31, IT: 2024-05-29, DE: 2024-05-29, NL: 2024-05-31, PL: 2024-05-31, HU: 2024-05-29, BG: 2024-06-03, ES: 2024-05-31, BE: 2024-06-05

Condition(s): chronic heart failure
Product: tovinontrine-matching placebo, immediate-release tablet, Tovinontrine

Primary endpoint: The percent change from baseline (pre-dose on Day 1) in plasma NT-proBNP at Week 12.
Endpoint(s): The percent change from baseline (pre-dose on Day 1) in urine and plasma cGMP at Week 12, The percent change from baseline (pre-dose on Day 1) in BNP at Week 12, The percent change from baseline (pre-dose on Day 1) in urine and plasma cGMP to NT-proBNP ratio at Week 12, The percent change from baseline (pre-dose on Day 1) in urine and plasma cGMP to BNP ratio at Week 12, The change from baseline (pre-dose on Day 1) in the KCCQ-23-CSS, KCCQ-23-OSS, and 8 domains (physical limitation, symptom stability, symptom frequency, symptom burden, total symptom score, quality of life, self-efficacy, and social limitation) at Week 12, The change from baseline (pre-dose on Day 1) of the proportion of patients with ≥5, 10, and 20-point improvement in the KCCQ-23-CSS at Week 12, The post-baseline NYHA classification at Week 12

Source: https://euclinicaltrials.eu/ctis-public/view/2023-508737-13-00